EU clinical trial 2024-512893-86-00: A DOUBLE-BLIND, RANDOMISED, PLACEBO-CONTROLLED PHASE I TRIAL TO INVESTIGATE SAFETY, TOLERABILITY AND PHARMACOKINETICS OF SINGLE ASCENDING TOPICAL DOSES OF GZ21T IN HEALTHY VOLUNTEERS
Sponsor: Ankh Life Sciences Limited (Pharmaceutical company). Phase: Human Pharmacology (Phase I)- Other. Countries: Sweden (ended).
Therapeutic area(s): Diseases [C] - Skin and Connective Tissue Diseases [C17]
Gender: Female, Male. Age: 18-64 years, 65+ years. Enrolment: 41.
Status: Ended. Start date (EU): 2024-08-06. End date (EU): 2025-03-31. Decision date: 2024-07-12. Results received: No. Last updated: 2025-01-30.

Condition(s): Actinic keratosis

Source: https://euclinicaltrials.eu/ctis-public/view/2024-512893-86-00